EU clinical trial 2026-526804-59-00: Real-World Effectiveness of the Adjuvanted RSVPreF3 Vaccine in Adults ≥60 Years: A Pragmatic Randomized Trial (BronquiVal)
Protocol code: Bronquival
Sponsor: Fundacion Para El Fomento De La Investigacion Sanitaria Y Biomedica De La Comunitat Valenciana (Patient organisation/association). Phase: Therapeutic use (Phase IV). Countries: Spain (authorised, recruitment pending).
Therapeutic area(s): Diseases [C] - Respiratory Tract Diseases [C08]
Gender: Female, Male. Age: 18-64 years, 65+ years. Enrolment: 100000.
Status: Authorised, recruitment pending. Decision date: 2026-07-22. Results received: No. Last updated: 2026-07-22.

Condition(s): Respiratory syncytial virus infection–related respiratory disease
Product: Arexvy powder and suspension for suspension for injection Respiratory Syncytial Virus (RSV) vaccine (recombinant, adjuvanted)

Primary endpoint: The primary endpoint of the study is the first occurrence of a hospitalisation for RSV-related RD (ICD-10 code for RSV infection as primary or secondary diagnosis position OR a relevant RD in any diagnose position AND RSV infection confirmed by laboratory test (Polymerase Chain Reaction, PCR or antigen) within 10 days prior to or up to 2 days after hospital admission.
Endpoint(s): RSV-related LRTD hospitalisations., RSV-related MACE hospitalisations., RSV-related COPD/Asthma exacerbations hospitalisations

Source: https://euclinicaltrials.eu/ctis-public/view/2026-526804-59-00